EU clinical trial 2024-515065-34-00: A Phase 2a, Randomised, Double-blind, Parallel and Placebo-controlled Trial Investigating Safety and Efficacy of LIB-01 in Treatment of Erectile Dysfunction
Protocol code: DCT4564
Sponsor: Dicot AB (Pharmaceutical company). Phase: Therapeutic exploratory (Phase II). Countries: Netherlands (ended), Denmark (ended), Sweden (ended).
Therapeutic area(s): Diseases [C] - Male Urogenital Diseases [C12]
Gender: Male. Age: 18-64 years, 65+ years. Enrolment: 140.
Status: Ended. Start date (EU): 2024-11-07. End date (EU): 2025-08-19. Decision date: 2024-10-14. Results received: Yes. Last updated: 2024-11-07.
Decision dates by country: DK: 2024-10-21, NL: 2024-10-15, SE: 2024-11-07

Condition(s): Erectile dysfunction (ED)
Product: LIB-01 MONOHYDRATE, LIB-01 MONOHYDRATE, LIB-01-placebo powder for suspension Vehicle: SyrSpend® SF PH4

Primary endpoint: Change from baseline in total score on the erectile function (EF) domain of the patient questionnaire International Index of Erectile Function (IIEF-EF) at week 4. Safety endpoint: Frequency, seriousness and intensity of adverse events (AEs), Clinically significant changes in safety laboratory measurements, vital signs and electrocardiogram (ECG).
Endpoint(s): Percentage of successful attempts by the Sexual Encounter Profile (SEP) question 2 throughout the trial period., Percentage of successful attempts by the SEP question 3 throughout the trial period., Percentage of improved erections by the Global Assessment Question (GAQ) at week 4 and week 8., IIEF-EF domain responder rate by minimally clinically important difference (MCID) at week 4 and week 8., Change from baseline in sub-domain scores (orgasmic function, sexual desire, intercourse satisfaction, overall satisfaction) of the patient questionnaire IIEF at week 4 and week 8., PK parameters of LIB-01 in plasma.

Source: https://euclinicaltrials.eu/ctis-public/view/2024-515065-34-00